EU clinical trial 2024-511702-23-00: Clinical Trial on PREnatal Dexamethasone In Congenital adrenal hyperplasia Therapy - PREDICT -
Protocol code: KKS-292
Sponsor: Philipps-Universitaet Marburg (Educational Institution). Phase: Therapeutic exploratory (Phase II). Countries: Germany (ongoing, recruiting).
Therapeutic area(s): Diseases [C] - Congenital, Hereditary, and Neonatal Diseases and Abnormalities [C16]; Diseases [C] - Hormonal diseases [C19]
Gender: Female. Age: In utero, 0-17 years, 18-64 years. Enrolment: 122.
Status: Ongoing, recruiting. Start date (EU): 2025-08-05. Decision date: 2024-11-19. Results received: No. Last updated: 2026-06-03.

Condition(s): Congenital adrenal hyperplasia
Product: Dexamethason 0.15mg, Dexamethason 0.21mg, Dexamethason 0.41mg, Dexamethason 0.5mg

Primary endpoint: Closure of urogenital sinus (Prader stage), Gestational weight gain (GWG) of mother
Endpoint(s): Parameters of treatment consequences/safety in treated mothers and children, safety parameters: stillbirths, miscarriages, maternal side effects and adverse events, serious adverse events (AEs, SAEs) in treated mothers and children, maternal quality of life, maternal mental health and sleep, child´s birth weight and height at birth, week of gestation at birth, infant nervous system development, malformations in the child)

Source: https://euclinicaltrials.eu/ctis-public/view/2024-511702-23-00